EU clinical trial 2025-521502-18-00: A Trial to Determine if Quabodepistat is Processed Differently in Adults with Reduced Liver Function Compared to Adults with Normal Liver Function
Protocol code: 323-201-00009
Sponsor: Otsuka Pharmaceutical Development & Commercialization Inc. (Pharmaceutical company). Phase: Human Pharmacology (Phase I)- Other. Countries: Bulgaria (ended).
Therapeutic area(s): Diseases [C] - Respiratory Tract Diseases [C08]
Gender: Female, Male. Age: 18-64 years, 65+ years. Enrolment: 32.
Status: Ended. Start date (EU): 2025-11-13. End date (EU): 2026-03-12. End date: 2026-03-13. Decision date: 2025-09-19. Results received: No. Last updated: 2026-03-05.

Condition(s): Tuberculosis

Source: https://euclinicaltrials.eu/ctis-public/view/2025-521502-18-00